EU clinical trial 2024-512583-57-00: A Randomized, Phase Ⅲ Study of Rilvegostomig in Combination with Fluoropyrimidine and Trastuzumab Deruxtecan versus Trastuzumab, Chemotherapy, and Pembrolizumab for the First line Treatment of HER2-positive Gastric Cancer (ARTEMIDE-Gastric01).
Protocol code: D702AC00001
Sponsor: AstraZeneca AB (Pharmaceutical company). Phase: Therapeutic confirmatory (Phase III). Countries: Netherlands (ongoing, recruiting), Hungary (ongoing, recruiting), Spain (ongoing, recruiting), Germany (ongoing, recruiting), France (ongoing, recruiting), Austria (ongoing, recruiting), Poland (ongoing, recruiting), Italy (ongoing, recruiting), Belgium (ongoing, recruiting).
Therapeutic area(s): Diseases [C] - Neoplasms [C04]
Gender: Female, Male. Age: 18-64 years, 65+ years. Enrolment: 204.
Status: Ongoing, recruiting. Start date (EU): 2025-07-30. Decision date: 2025-05-27. Results received: No. Last updated: 2026-06-30.
Decision dates by country: AT: 2025-06-02, FR: 2025-05-27, DE: 2025-05-28, HU: 2025-06-02, IT: 2025-07-28, ES: 2025-05-29, PL: 2025-06-01, BE: 2025-05-27, NL: 2025-06-02

Condition(s): HER2-positive locally advanced or metastatic gastric or gastroesophageal junction adenocarcinoma.
Product: CAPECITABINE, MYCOPHENOLATE MOFETIL, DS-8201a, CISPLATIN, FLUOROURACIL, KEYTRUDA 25 mg/mL concentrate for solution for infusion, CAPECITABINE, TRASTUZUMAB, Rilvegostomig, OXALIPLATIN, INFLIXIMAB

Primary endpoint: Progression-free Survival (PFS) per RECIST v1.1, Overall Survival (OS)
Endpoint(s): PFS based on RECIST v1.1., Objective Response Rate (ORR) according to RECIST v1.1., Duration of Response (DoR) according to RECIST v1.1., Time to second progression or death., Progression-free Survival (PFS) at 6 and 12 months (PFS6 and PFS12)., Overall Survival (OS) at 12 and 24 months (OS12 andOS24)., Occurrence of AEs, SAEs, AESIs., Changes from baseline in laboratory parameters, vitalsigns, electrocardiogram data, and results ofechocardiogram/multiple gated acquisition., Serum concentration of rilvegostomig, T-DXd, total anti-HER2 antibody, T-DXd, plasma concentration of 5-FU andcapecitabine., Presence of anti-drug antibodies for rilvegostomig and T-DXd., Time to initiation of enteral feeding assistance and/or increase eating difficulties., The proportion of time on study intervention with highside-effect bother., The proportion of participants with stable or improvedphysical function while on treatment.

Source: https://euclinicaltrials.eu/ctis-public/view/2024-512583-57-00